EU clinical trial 2023-505539-11-00: An Open-Label Extension Study to Assess the Safety, Tolerability, and Effectiveness of the Long-Term use of Treprostinil Palmitil Inhalation Powder in Participants with Pulmonary Arterial Hypertension
Protocol code: INS1009-203
Sponsor: Insmed Inc. (Pharmaceutical company). Phase: Phase II and Phase III (Integrated). Countries: Austria (ended), Belgium (ongoing, recruitment ended), Denmark (ongoing, recruitment ended), Germany (ongoing, recruitment ended), Spain (ongoing, recruitment ended), Italy (ongoing, recruitment ended).
Therapeutic area(s): Diseases [C] - Respiratory Tract Diseases [C08]
Gender: Female, Male. Age: 18-64 years, 65+ years. Enrolment: 23.
Start date (EU): 2023-04-06. Decision date: 2024-09-13. Results received: No. Last updated: 2026-07-10.
Decision dates by country: AT: 2024-09-15, DK: 2024-09-13, BE: 2024-09-13, ES: 2024-09-16, DE: 2024-09-16, IT: 2024-10-16

Condition(s): Pulmonary Arterial Hypertension
Product: Placebo (inhalation powder capsules) containing 1 of 3 dosage strengths of TPIP (80 μg, 160 μg, or 320 μg), TREPROSTINIL PALMITIL INHALATION POWDER, TREPROSTINIL PALMITIL INHALATION POWDER, TREPROSTINIL PALMITIL INHALATION POWDER

Primary endpoint: Frequency and severity of TEAEs during the study
Endpoint(s): Change from pre-OLE baseline to Month 6, Month 12, Month 18, and Month 24 in 6MWD (absolute and relative), in the concentration of NT proBNP in blood, in the REVEAL Lite 2.0 score, in NYHA/WHO functional capacity class., Annualized rate of clinical worsening events defined as one of the following: - All cause death, or onset of TEAE with a fatal outcome occurring ≤ 14 days after study drug discontinuation. - Hospitalization for right heart failure (for > 48 hours), heart lung or lung transplant, or atrial septostomy, Addition (or increase in dose) of specified PAH-specific medications. Combined occurrence of events including a 20% decrease in 6MWD, worsening WHO/NYHA functional capacity class, and appearance of or worsening of signs/symptoms of right heart failure. Annualized clinical worsening event rate defined as the total number of clinical worsening events that occurred during the treatment period divided by the total number of participant-years during the treatment period., Plasma concentration levels of TP and TRE

Source: https://euclinicaltrials.eu/ctis-public/view/2023-505539-11-00